EU clinical trial 2024-512387-56-00: A randomized, placebo-controlled, double-blind, 2-period cross-over study in youth with autism spectrum disorders evaluating social and repetitive behaviors after four weeks of twice daily-doses of 24IU of intranasally administered oxytocin
Sponsor: Oslo University Hospital HF (Hospital/Clinic/Other health care facility). Phase: Therapeutic exploratory (Phase II). Countries: Norway (authorised, recruitment pending).
Therapeutic area(s): Psychiatry and Psychology [F] - Psychological Phenomena [F02]; Psychiatry and Psychology [F] - Behavior and Behavior Mechanisms [F01]
Gender: Female, Male. Age: 0-17 years, 18-64 years. Enrolment: 128.
Status: Authorised, recruitment pending. Decision date: 2024-10-09. Results received: No. Last updated: 2024-10-09.

Condition(s): Autism spectrum disorder
Product: Natriumklorid Fresenius Kabi 9 mg/ml infusjonsvæske, oppløsning, SYNTOCINON® 6,7 mikrog/dose nesespray, oppløsning

Primary endpoint: The effect of 24 IU oxytocin delivered intranasally, twice-daily, for four weeks, on social behavior. This will be operationalized as change from baseline on performance on the Social Responsiveness Scale-Second Edition (SRS-2), completed by caregivers of the participants., The effect of 24 IU oxytocin delivered intranasally, twice-daily, for four weeks, on repetitive behavior. This will be operationalized as change from baseline on performance on the Repetitive Behavior Scale-Revised (RBS-R) scale, completed by caregivers of the participants.
Endpoint(s): The effect of 24 IU oxytocin delivered intranasally, twice-daily, for four weeks, on behavioral inflexibility. This will be operationalized as change from baseline on performance on the Behavioral Inflexibility scale (BIS), completed by caregivers of the research participants

Source: https://euclinicaltrials.eu/ctis-public/view/2024-512387-56-00